EU clinical trial 2023-510000-45-00: A phase 2/3 prospective, multicentre randomized, double-blind trial, comparing intra-discal allogeneic adult BM-MSC therapy and sham-treated controls in subjects with chronic low back pain due to lumbar degenerative disc disease (DDD) unresponsive to conventional therapy
Protocol code: 9766_RECHMPL17_0206
Sponsor: Centre Hospitalier Universitaire De Montpellier (Hospital/Clinic/Other health care facility). Phase: Phase II and Phase III (Integrated). Countries: Germany (ended).
Therapeutic area(s): Diseases [C] - Musculoskeletal Diseases [C05]
Gender: Female, Male. Age: 18-64 years. Enrolment: 11.
Status: Ended. Start date (EU): 2020-07-12. End date (EU): 2026-03-09. Decision date: 2024-11-19. Results received: No. Last updated: 2026-02-10.

Condition(s): Degenerative Disc Disease
Product: MSV Allogenic bone marrow stromal mesenchymal cells

Primary endpoint: Clinical response is defined as pain relief of at least 20% and 20 mm decrease on VAS scale between baseline and month 12, or 20% improvement of functional index ODI at month 12 compared to baseline. VAS pain scale (0 – 100, where 0 represents no pain and 100 represents the worst pain imaginable). Oswestry disability index scale ranges from 0 to 50 (0%–20%:minimal disability; 20%–40%:moderate disability; 40%–60%:severe disability; 60%–80%:crippled; 80%–100%:bed-bound/exaggerating their symptoms, Fluid content of the discs will be determined from T2-weighted sagittal images, and measured in the affected disc segment and in the contiguous 3 to 5 segments (Methods and Orozco et al). The fluid content values of the affected discs will be normalized to the values obtained from the healthy discs in the same individual (average value of the healthy discs). The change in fluid content is expressed as the ratio of fluid content at months 12 vs fluid content at baseline., Evolution of affected disc(s) by quantitative Magnetic Resonance Imaging (MRI) density measurements in T2 and T1spin/echo and T1rho weighted images performed at screening, 12 and 24 months used as an indication of disc fluid and GAG content. The "quality" of the patient's lumbar disc will be monitored non-invasively using T2-weighted MRI sagittal images and, in T1spin/echo MRI.
Endpoint(s): Disability and quality of life evolution include Short Form (SF)-36 scores, global assessment by the patient and the physician. Overall pain intensity in the lumbar spine (1 = none, 2 = mild, 3 = moderate, 4 = severe, 5 = extreme); patient's global assessment of disease activity (1 = very good, 2 = good, 3 = fair, 4 = poor, 5 = very poor); physician's global assessment of disease activity (1 = very good, 2 = good, 3 = fair, 4 = poor, 5 = very poor), de-/increase in rescue painkillers medication, drug consumption of painkillers, Employment and work status, medical and non-medical costs, Immune response, Safety Outcomes

Source: https://euclinicaltrials.eu/ctis-public/view/2023-510000-45-00